EU clinical trial 2022-502019-12-00: FLUCLORIC - Randomized multicentric Phase III study comparing the efficacy of two reduced intensity conditioning regimens (clofarabine/busulfan versus fludarabine/busulfan) in adults with acute myeloid leukemia and eligible to allogeneic stem cell transplantation: a SFGM-TC study
Sponsor: Centre Hospitalier Universitaire De Nantes (Hospital/Clinic/Other health care facility). Phase: Therapeutic confirmatory (Phase III). Countries: France (ongoing, recruiting).
Therapeutic area(s): Diseases [C] - Hemic and Lymphatic Diseases [C15]
Gender: Female, Male. Age: 18-64 years, 65+ years. Enrolment: 302.
Status: Ongoing, recruiting. Start date (EU): 2023-09-14. Decision date: 2023-04-27. Results received: No. Last updated: 2026-07-09.

Condition(s): acute myeloid leukemia
Product: FLUDARABINE, FLUCORTAC 50 microgrammes, comprimé sécable, CellCept 250 mg capsules, CLOFARABINE, BUSULFAN, NEORAL® Soft Gelatin Capsules 10mg, ANTI-T LYMPHOCYTE IMMUNOGLOBULIN FOR HUMAN USE, RABBIT

Primary endpoint: OS is defined as the time from day 1 of the conditioning to death or last follow-up for survivors
Endpoint(s): -Engraftment: PNN >500/mm3 + donor chimerism >=5% (day +30/42) -Primary and secondary graft failure: donor chimerism <5% at day +30/42 post-transplant (primary) or at distance of transplant after achieving engraftment (secondary), -Neutrophils recovery: the first of three consecutive days with neutrophils ≥500/mm3 after aplasia from day 0 of the graft -Platelets recovery: the first of three consecutive days with platelets ≥20000/mm3 without transfusion after aplasia from day 0 of the graft, DFS: time from day 1 of the conditioning to time without death or evidence of relapse or disease progression censored at the date of last follow-up., Relapse: any event related to progression or re-occurrence of the disease from day 1 of the conditioning, NRM: death from any cause without previous relapse or progression from day 1 of the conditioning, Acute GVHD: NIH criteria, Chronic GVHD: NIH criteria, GRFS: alive with no previous grade III-IV acute GvHD, no moderate or severe chronic GvHD and no relapse from day 1 of the conditioning, Chimerism: peripheral blood and CD3 T cells by molecular markers at days +30, +60, +90/100, Immune reconstitution: Immunophenotype of PB lymphocytes and EPP: CD4, CD8, B, NK, EPP at 3, 6, 9 and 12 months, Minimal residual disease (MRD): before transplant, at day +30/60 and dayd+90/100 by flow cytometry, molecular biology and NGS (if available) (ELN 2022 recommendation, Dohner et al Blood 2022), Comparison of infections after FB2A2 vs CloB2A2: bacterial, viral, parasitic and fungal between day 0 and day+90/100, Quality of life: EORTC QLQ-C30 (European Organization for Research and Treatment of Cancer Quality of Life Questionnaire-Core 30) and FACT-BMT (Functional Assessment of Cancer Therapy - Bone Marrow Transplant). at D-7, D30, D90, D180 and D360, Graft hospitalization: Comparison between both groups in terms of length of stay (in days), use of antibiotics (type and length in days) and blood products (numbers), General Health State with Euroqol EQ-5D-5L questionnaire at D-7, D30, D90, D180, D360 and D720., Health Economic study: Incremental cost-utility ratio (ICUR, cost per quality-adjusted life year [QALY] gained) and incremental cost-effectiveness ratio (ICER, cost per life year gained), from a collective perspective and with a 24-month time horizon, Comparison of outcomes betwwen patients in first vs second line therapy and impact of clofarabine vs fludaribine in each sub-group: OS, DFS, RI, NRM, Comparison of outcomes between patients receiving a first vs a second allograft and impact of clofarabine vs fludarabine in each sub-group: OS, DFS, RI, NRM, dosage of leukemics blasts at diagnosis or at relapse and description of immune sub-population reconstitution post allograft (at inclusion, months 3, 6, 9 and 12)., Comparison of occurrence of veno-occlusive disease : (Mohty et al, BMT 2016) between day 0 and day+90/100, Safety assessment: the safety assessment shall be done by collecting all adverse events that occur during the research. All adverse event (except GvHD) shall be graded according to CTC-AE Toxicity Grading Scale (version 5).

Source: https://euclinicaltrials.eu/ctis-public/view/2022-502019-12-00